EU clinical trial 2024-515027-11-00: A Phase 2b, Randomized, Double-Blind Long-Term Extension Study to Evaluate Pharmacokinetics, Efficacy, Safety, and Tolerability of TEV-48574 in Adult Patients with Moderate to Severe Ulcerative Colitis or Crohn’s Disease who completed the treatment phase of the Dose-Ranging Study (RELIEVE UCCD LTE)
Protocol code: TV48574-IMM-20038
Sponsor: Teva Branded Pharmaceutical Products R&D LLC (Pharmaceutical company). Phase: Therapeutic exploratory (Phase II). Countries: Austria (ongoing, recruitment ended), Slovakia (ongoing, recruitment ended), Hungary (ongoing, recruitment ended), Germany (ongoing, recruitment ended), Spain (ongoing, recruitment ended), Czechia (ongoing, recruitment ended), Italy (ongoing, recruitment ended), Norway (ongoing, recruitment ended), Bulgaria (ongoing, recruitment ended), Poland (ongoing, recruitment ended).
Therapeutic area(s): Diseases [C] - Digestive System Diseases [C06]
Gender: Female, Male. Age: 18-64 years, 65+ years. Enrolment: 184.
Status: Ongoing, recruitment ended. Start date (EU): 2023-06-29. Decision date: 2024-09-24. Results received: No. Last updated: 2025-12-05.
Decision dates by country: BG: 2024-10-04, ES: 2024-09-25, CZ: 2024-09-25, IT: 2024-10-01, HU: 2024-09-25, DE: 2024-09-26, NO: 2024-10-01, AT: 2024-09-29, PL: 2024-10-07, SK: 2024-09-24

Condition(s): Crohn’s disease, Ulcerative colitis
Product: TEV-48574

Primary endpoint: 1.Clinical remission based on modified (9-point rectal bleeding, stool frequency, and endoscopy) Mayo score of ≤2 points defined by a stool frequency subscore of 0 or 1, rectal bleeding subscore of 0, and an endoscopic subscore of 0 or 1, where a score of 1 does not include “friability” at week 44 in patients with UC, 2. Endoscopic response, defined as a decrease in Simple Endoscopic Score for Crohn’s Disease (SES-CD) of at least 50% from dose-range finding (DRF) study baseline at week 44 in patients with CD
Endpoint(s): 1. Clinical response, based on modified (9-point rectal bleeding, stool frequency, and endoscopy) Mayo score of at least 2 points AND at least a 30% reduction from DRF study baseline with either a decrease in rectal bleeding subscore of at least 1 or an absolute rectal bleeding subscore of less than or equal to 1 at week 44 in patients with UC, 2. Endoscopic improvement from DRF study baseline based on Mayo endoscopic subscore of 0 or 1 at week 44 in patients with UC, 3. Endoscopic remission based on Mayo endoscopic subscore of 0 at week 44 in patients with UC, 4. Corticosteroid-free clinical remission based on the modified Mayo score at week 44, defined by clinical remission (see primary endpoint) and corticosteroid free for ≥12 weeks preceding week 44, in patients with UC., 5. Clinical response based on Crohn’s Disease Activity Index (CDAI): ≥100-point decrease in CDAI score from DRF study baseline in patients with CD at week 44, 6. Clinical remission based on CDAI score <150 at week 44 in patients with CD, 7. Corticosteroid-free endoscopic response based on SES-CD at week 44, defined by endoscopic response (see primary endpoint) and corticosteroid-free for ≥12 weeks preceding week 44, in patients with CD, 8. Corticosteroid-free clinical remission based on CDAI at week 44, defined by a CDAI score of <150 points and corticosteroid-free for ≥12 weeks preceding week 44, in patients with CD, 9. Adverse events Adverse events can include any of the following clinically significant changes in clinical laboratory test results (serum chemistry, hematology, and urinalysis), vital signs measurements (blood pressure, pulse rate, body temperature, and respiratory rate), 12-lead electrocardiogram (ECG), and injection site reactions, 10. Patients who stopped the investigational medicinal product due to adverse events, 11. Treatment-emergent anti-drug antibody (ADA), 12. Neutralizing ADA in ADA positive patients throughout the study

Source: https://euclinicaltrials.eu/ctis-public/view/2024-515027-11-00